EU clinical trial 2024-518931-12-00: BEACON: A randomised phase IIb trial of BEvACizumab added to Temozolomide ± IrinOtecan for children with refractory/relapsed Neuroblastoma
Protocol code: RG_11-087
Sponsor: The University Of Birmingham (Educational Institution). Phase: Therapeutic exploratory (Phase II). Countries: Belgium (ended), Spain (ended), Netherlands (ended), France (ended), Denmark (ended).
Therapeutic area(s): Diseases [C] - Neoplasms [C04]
Gender: Female, Male. Age: 0-17 years. Enrolment: 122.
Status: Ended. Start date (EU): 2014-05-15. End date (EU): 2026-02-18. End date: 2026-04-29. Decision date: 2024-11-13. Results received: No. Last updated: 2024-11-25.
Decision dates by country: BE: 2024-11-25, DK: 2024-11-15, FR: 2024-11-19, ES: 2024-11-13, NL: 2024-11-13

Condition(s): Neuroblastoma
Product: TEMOZOLOMIDE, TEMOZOLOMIDE, DINUTUXIMAB BETA, TEMOZOLOMIDE, IRINOTECAN, TEMOZOLOMIDE, BEVACIZUMAB, TEMOZOLOMIDE, CYCLOPHOSPHAMIDE, TEMOZOLOMIDE, TOPOTECAN

Primary endpoint: Best response (Complete Response [CR], or Partial Response [PR](Brodeur et al. 1988) at any time during the first 6 cycles of trial treatment, For the bevacizumab part 2 only: Progression-free survival (PFS)
Endpoint(s): Safety of the regimens: Incidence and severity of Adverse Events (AE), PFS, Event-free survival (EFS), Overall survival (OS)

Source: https://euclinicaltrials.eu/ctis-public/view/2024-518931-12-00